EU clinical trial 2024-520097-36-00: A Phase 3, Randomized, Double-Blinded, Double-Dummy Study Evaluating the Efficacy and Safety of Intravenous Empasiprubart Versus Intravenous Immunoglobulin in Adults With Chronic Inflammatory Demyelinating Polyneuropathy
Protocol code: ARGX-117-2401
Sponsor: Argenx (Pharmaceutical company). Phase: Therapeutic confirmatory (Phase III). Countries: Czechia (ongoing, recruiting), Bulgaria (ended), Netherlands (ongoing, recruiting), Hungary (authorised, recruiting), Sweden (authorised, recruiting), Slovakia (authorised, recruiting), Slovenia (ongoing, recruiting), Greece (ongoing, recruiting), Norway (ongoing, recruiting), Poland (ongoing, recruiting), Italy (ongoing, recruiting), Spain (ongoing, recruiting), Estonia (ongoing, recruiting), Denmark (authorised, recruiting), France (ongoing, recruiting), Romania (ongoing, recruiting), Portugal (authorised, recruiting), Austria (ongoing, recruiting), Germany (ongoing, recruiting).
Therapeutic area(s): Diseases [C] - Nervous System Diseases [C10]
Gender: Female, Male. Age: 18-64 years, 65+ years. Enrolment: 108.
Start date (EU): 2026-01-07. Decision date: 2025-12-01. Results received: No. Last updated: 2026-04-29.
Decision dates by country: BG: 2025-12-04, GR: 2025-12-02, NL: 2025-12-02, AT: 2025-12-01, PT: 2025-12-02, EE: 2025-12-04, SK: 2025-12-01, RO: 2025-12-08, DE: 2025-12-05, DK: 2025-12-01, IT: 2025-12-03, CZ: 2025-12-02, FR: 2025-12-02, SI: 2025-12-04, SE: 2025-12-08, NO: 2025-12-02, HU: 2026-02-02, ES: 2025-12-09, PL: 2026-02-12

Condition(s): Chronic inflammatory demyelinating polyneuropathy (CIDP)
Product: HUMAN NORMAL IMMUNOGLOBULIN (IV), Placebo for empasiprubart- solution for IV infusion, Placebo for IVIg - solution for IV infusion, ARGX-117

Primary endpoint: Decrease of ≥1 point compared with baseline in aINCAT score at week 24
Endpoint(s): 1. Change from baseline in Inflammatory Rasch-built Overall Disability Scale (I-RODS) centile points score at week 24, 2. Change from baseline in Medical Research Council Sum Score (MRC-SS) at week 24, 3. Change from baseline in grip strength (3-day moving average) in the dominant hand at week 24, 4. Time to reduction of ≥1 point from baseline in aINCAT score, 5. Change from baseline in Timed Up and Go (TUG) at week 24, 6. Time to increase of ≥1 point compared with baseline in aINCAT score by week 24, 7. Change from baseline in grip strength (3-day moving average) of both hands over time and change from baseline in grip strength (daily average) for both hands, 8. Change from baseline in aINCAT over time, 9. Change from baseline in I-RODS centile points score over time, 10. Change from baseline in MRC-SS over time, 11. Change from baseline in TUG over time, 12. Change from baseline in EQ-5D-5L, RT-FSS, SF-12 and BPI-SF over time, 13. PGI-S and PGI-C values over time, 14. Values for work-related and household chore activities of the HRPQ, 15. Percentage of scheduled hours lost in total (absenteeism + presenteeism), 16. Incidence and prevalence of antidrug antibodies and neutralizing antibodies against empasiprubart in serum, 17. Incidence and severity of adverse events, incidence of serious adverse events and clinically meaningful changes in laboratory parameters, ECG results, and vital signs, 18. Absolute values and percentage change from baseline in free C2 and total C2 over time, 19. Serum concentrations of empasiprubart over time

Source: https://euclinicaltrials.eu/ctis-public/view/2024-520097-36-00